EU clinical trial 2023-504036-17-00: A Prospective, Open-Label, Multicenter Randomized Phase III Study to Compare the Efficacy and Safety of a Combined Regimen of Venetoclax and Obinutuzumab Versus Fludarabine, Cyclophosphamide, and Rituximab (FCR)/ Bendamustine and Rituximab (BR) in FIT Patients with previously untreated Chronic Lymphocytic Leukemia (CLL) without DEL(17P) or TP53 Mutation
Protocol code: CO41685
Sponsor: F. Hoffmann-La Roche AG (Pharmaceutical company). Phase: Therapeutic confirmatory (Phase III). Countries: Spain (ended), France (ended), Italy (ended).
Therapeutic area(s): Diseases [C] - Neoplasms [C04]
Gender: Female, Male. Age: 18-64 years, 65+ years. Enrolment: 121.
Status: Ended. Start date (EU): 2020-05-07. End date (EU): 2025-03-18. End date: 2025-03-20. Decision date: 2024-07-29. Results received: Yes. Last updated: 2025-04-17.
Decision dates by country: ES: 2024-07-29, FR: 2024-07-29, IT: 2024-07-31

Condition(s): Chronic Lymphocytic Leukemia (CLL)
Product: Venclexta, Venclyxto, Levact 2,5 mg/ml Pulver für ein Konzentrat zur Herstellung einer Infusionslösung, Venclexta, Venclyxto, Fludarabinphosphat "Ebewe", koncentrat til injektions-/infusionsvæske, opløsning, Venclexta, Venclyxto, Fludarabin Ebewe 25 mg/ml injektio-/infuusiokonsentraatti, liuosta varten, Fludarabin Sandoz 25 mg/ml injekčný alebo infúzny koncentrát, MabThera 500 mg concentrate for solution for infusion, Levact 2,5 mg/ml poudre pour solution à diluer pour perfusion, Bendamustin cell pharm® 2,5 mg/ml Pulver für ein Konzentrat zur Herstellung einer Infusionslösung, Endoxan, Fludarabine „Ebewe” 25 mg/ml, süste-/infusioonilahuse kontsentraat, Neoflubin 25 mg/ml Konzentrat zur Herstellung einer Injektions- oder Infusionslösung, Gazyvaro 1,000 mg concentrate for solution for infusion.

Primary endpoint: 1. MRD response rate measured in PB using next‑generation sequencing (NGS) at Month 15
Endpoint(s): 1. Progression-free survival, 2. MRD response rate, in PB at end of treatment response visit, 3. MRD response rate in BM at end of treatment response visit, 4. ORR which includes complete remission (CR), complete remission with incomplete blood count recovery (Cri), and partial response (PR) at the Month 15 assessment, 5. Complete response rate at the Month 15 assessment, 6. MRD response rate in PB in patients with a complete remission /complete remission with incomplete blood count recovery (CR/Cri) at Month 15, 7. MRD response rate in BM in patients with a CR/CRi at end of treatment visit, 8. Best response up to and including the Month 15 assessment, 9. Duration of objective response, 10. Event-free survival, 11. Overall survival, 12. Tumor lysis syndrome risk reduction rate in Arm A, 13. Reduction in mandatory hospitalizations during venetoclax ramp-up in Arm A, 14. Changes in vital signs, physical findings, and clinical laboratory test results during and following study treatment, 15. Premature withdrawals, 16. Change in disease and treatment-related symptoms following treatment with the combination of VEN + G compared with FCR/BR in patients with previously untreated CLL without del (17p) or TP53 mutation as measured by MDASI-CLL, 17. Change in physical functioning, role functioning and health-related quality of life following treatment with the combination of VEN + G compared with FCR/BR in patients with previously with previously untreated CLL without del(17p) or TP53 mutation as measured by EORTC QLQ-C30, 18. Nature, frequency, and severity of adverse events and serious adverse event

Source: https://euclinicaltrials.eu/ctis-public/view/2023-504036-17-00